EU clinical trial 2025-521013-10-00: A RANDOMIZED, DOUBLE-BLIND, PLACEBO-CONTROLLED, PARALLEL-GROUP, MULTICENTER, PHASE 2B TRIAL TO ASSESS THE EFFICACY, SAFETY, AND TOLERABILITY OF AEF0217 FOR 24 WEEKS IN ADULTS AND OLDER ADOLESCENTS WITH DOWN SYNDROME
Protocol code: AEF0217-201
Sponsor: Aelis Farma (Pharmaceutical company). Phase: Therapeutic exploratory (Phase II). Countries: Spain (ongoing, recruiting), Italy (ongoing, recruiting), France (ongoing, recruiting).
Therapeutic area(s): Diseases [C] - Congenital, Hereditary, and Neonatal Diseases and Abnormalities [C16]
Gender: Female, Male. Age: 0-17 years, 18-64 years. Enrolment: 188.
Status: Ongoing, recruiting. Start date (EU): 2025-12-11. Decision date: 2025-11-17. Results received: No. Last updated: 2026-07-20.
Decision dates by country: FR: 2025-11-17, IT: 2025-11-17, ES: 2025-11-17

Condition(s): Treatment of behavioural and cognitive impairments in Down syndrome.
Product: AEF0217 Placebo

Primary endpoint: Normalized raw scores of the 9 subdomains of the VABS-3: Change from baseline to end of Week 24 (end of treatment) of the normalized 9 subdomains of the VABS-3.
Endpoint(s): 01. The fluid cognition composite change sensitive score of the NIH-ToolBox for ID: Changes from baseline to the end of Week 24 (end of treatment) in the fluid cognition composite change sensitive score of the NIH-TCB for ID, 02. The 5 individual scores of the tests used to measure the fluid cognition composite change sensitive score in the NIH-TCB for ID o Secondary endpoint: Changes from baseline to end of Week 24 (end of treatment) in the 5 individual change sensitive scores of the tests used to measure fluid cognition in the NIH-TCB for ID., 03. VCI of the WISC-V : Changes from screening values used as baseline to the end of Week 24 (end of treatment) of the VCI of the WISC-V., 04. Normalized scores of the 2 individual tests (vocabulary and similarities) comprising the VCI of the WISC-V Changes from screening values used as baseline to the end of Week 24 (end of treatment) in the 2 individual tests (vocabulary and similarities) comprising the VCI from the WISC-V, 05. Total score of each scale of the Peds-QL 1. Generic Core scale; 2. Cognitive Functioning scale; 3. Impact Family Questionnaire : Changes from baseline to the end of Week 24 (end of treatment) of the total score of each scale of the Peds-QL., 06. Summary scores of the different dimensions of the Peds-QL: 1. Psychosocial Health; 2. Physical Health; 3. Parent HRQL; 4. Family Functioning: Changes from baseline to end of Week 24 (end of treatment) of each summary scores of the different dimensions of the Peds-QL., 07. Normalized mean scale scores of the domains of the Peds-QL scales containing domains: 1. Generic Core scale (4 domains); 2. Impact Family Questionnaire (8 domains):- Changes from baseline to end of Week 24 (end of treatment) of each mean scale scores of the different domains of the 2 scales of the Peds-QL containing domains, analysed by scale after normalisation to 100, 09. The number of participants reporting a TEAE (n), the percentage of participants with an event (%), and the number of events reported (AEs and TEAEs) will be presented by treatment groups., 10. The incidence of treatment-related and not related TEAEs will be tabulated by MedDRA SOC and PT and compared between treatment groups., 11. TEAEs will be also summarized by severity (mild, moderate, severe) outcome and action taken with study drug., 12. The incidence of treatment-emergent SAEs and related treatment emergent SAEs will be tabulated., 13. Vital signs (cardiovascular and body temperature) from Day 1 to end of trial and over time,, 14. Clinical safety laboratory parameters (chemistry, haematology and urinalysis) from Day 1 to end of trial and over time,, 15. ECG from Day 1 to end of trial and over time., 16. Changes from baseline at the end of Week 24 (end of treatment) and end of Week 32 (end of trial) in the total score of the ADAMS., 17. Changes from baseline at the end of Week 24 (end of treatment) and end of Week 32 in the scores of each of the 5 subscales (maniac/hyperactive behaviour; depressed mood; social avoidance; general anxiety; and compulsive behaviour)., 08. Sleep efficiency score of the PSQI : Changes from baseline to the end of Week 24 (end of treatment) for the sleep efficiency score of the PSQI.

Source: https://euclinicaltrials.eu/ctis-public/view/2025-521013-10-00